EU clinical trial 2026-525640-14-00: A multicenter, randomized, double-blind, placebo-controlled, adaptive, non-inferiority trial to investigate shortening treatment duration in uncomplicated candidemia: the CanTEN trial
Protocol code: uni-koeln-5745
Sponsor: University Of Cologne (Educational Institution). Phase: Therapeutic use (Phase IV). Countries: Germany (authorised, recruitment pending).
Therapeutic area(s): Diseases [C] - Bacterial Infections and Mycoses [C01]
Gender: Female, Male. Age: 18-64 years, 65+ years. Enrolment: 420.
Status: Authorised, recruitment pending. Decision date: 2026-05-28. Results received: No. Last updated: 2026-05-28.

Condition(s): Candidemia
Product: SODIUM LACTATE, CASPOFUNGIN ACETATE, CASPOFUNGIN ACETATE, SALINE

Primary endpoint: Rate of recurrent candidemia and/or other proven invasive candidiasis at 30 days after end of study treatment (Day 37).
Endpoint(s): Time from randomization to recurrent candidemia and/or other proven invasive candidiasis., Clinical cure, radiological cure and mycological eradication at end of study treatment (Day 7)., Clinical cure, radiological cure and mycological eradication at 30 days after end of study treatment (Day 37)., All-cause mortality at 30 days after end of study treatment (Day 37)., Mortality attributable to candidemia and/or other proven invasive candidiasis at 30 days after end of study treatment, as determined by the DSMB., Candidemia-attributable healthcare resources at 30 days after end of study treatment, including length of stay in ICU or IMC or general ward, duration of mechanical ventilation, cost of antifungal therapy since onset of candidemia., Caspofungin-related adverse events (AEs) occurring until 30 days after last administration of caspofungin., Patient reported outcome measures (PROMs) on Day 1 and Day 37: Health-related quality of life as per EQ-5D-5L , Physical functioning as per WHODAS 2.0.

Source: https://euclinicaltrials.eu/ctis-public/view/2026-525640-14-00